EU clinical trial 2024-514060-10-00: Multicenter, Open-label, Single arm, Phase II Clinical Trial to Improve Sacituzumab Govitecan Tolerance in Patients with Metastatic Triple-Negative or Luminal Breast Cancer. – The PRIMED Study –
Protocol code: MEDOPP445
Sponsor: Medica Scientia Innovation Research S.L. (Pharmaceutical company). Phase: Therapeutic exploratory (Phase II). Countries: Spain (ended).
Therapeutic area(s): Diseases [C] - Neoplasms [C04]
Gender: Female, Male. Age: 18-64 years, 65+ years. Enrolment: 50.
Status: Ended. Start date (EU): 2023-02-02. End date (EU): 2025-11-05. Decision date: 2024-06-20. Results received: No. Last updated: 2025-10-03.

Condition(s): Advanced triple-negative breast cancer (TNBC), Advanced HR[+]/HER2[–] breast cancer.
Product: Accofil 30 MU/0.5 ml solution for injection or infusion in pre-filled syringe, Neupogen Singleject 48 MU (0.96 mg/ml) solution for injection in a pre-filled syringe filgrastim, Neupogen Singleject 30 MU (0.6 mg/ml) solution for injection in a pre-filled syringe filgrastim, Zarzio 48 MU/0.5 ml solution for injection or infusion in pre-filled syringe, Loperamide Hydrochloride 2mg Tablets, Trodelvy 200 mg powder for concentrate for solution for infusion

Primary endpoint: Co-primary endpoints: Incidence of grade ≥2 diarrhea as assessed by the Investigator, with severity determined by the National Cancer Institute Common Terminology Criteria for Adverse Events version 5.0 (NCI-CTCAE v.5.0) at cycle 2., Co-primary endpoints: Incidence of grade ≥3 neutropenia as assessed by the Investigator, with severity determined by NCI-CTCAE v.5.0 at cycle 2.
Endpoint(s): Incidence of all grades and grade ≥3 diarrhea., Incidence of all grades and grade ≥3 neutropenia, Incidence of febrile neutropenia and additional adverse events (AEs) as per NCI-CTCAE v.5.0., Discontinuation rate., Dose reduction rate, Objective response rate (ORR)., Clinical benefit rate (CBR), Duration of response (DoR)., Time to response (TtR)., Best percentage of change from baseline in the size of target tumor lesions., Progression-free survival (PFS)., Exploratory endpoints: Relationship between tumor-related biomarkers and treatment efficacy (mutational tumor load; cytokine profiling; etc.), Exploratory endpoints: Changes in mutation and copy number in oncogenes, tumor suppressors, and/or other genes associated with disease progression assessed in liquid biopsy and/or tumor tissue., Exploratory endpoints: Changes in gut microbiome and metabolomic profile in stool samples.

Source: https://euclinicaltrials.eu/ctis-public/view/2024-514060-10-00